EU clinical trial 2023-508371-36-00: A Study in Healthy Adult Male Participants to Evaluate the Metabolism of [14C]PF-06821497
Protocol code: C2321007
Sponsor: Pfizer Inc. (Pharmaceutical company). Phase: Human Pharmacology (Phase I)- Other. Countries: Netherlands (ended).
Therapeutic area(s): Diseases [C] - Neoplasms [C04]
Gender: Male. Age: 18-64 years. Enrolment: 6.
Status: Ended. Start date (EU): 2024-07-15. End date (EU): 2024-11-11. End date: 2024-11-12. Decision date: 2024-05-28. Results received: No. Last updated: 2024-07-08.

Condition(s): small cell lung cancer (SCLC), castration resistant prostate cancer (CRPC), follicular lymphoma (FL)

Source: https://euclinicaltrials.eu/ctis-public/view/2023-508371-36-00